EU clinical trial 2024-520414-21-00: “Intravenous Thrombolysis With Tenecteplase Plus Thrombectomy Versus Thrombectomy Alone In Patients With A Large Ischemic Stroke: A Multicentre Randomized Controlled Trial” THE IVT ALL IN TRIAL
Protocol code: APHP240911
Sponsor: Assistance Publique Hopitaux De Paris (Hospital/Clinic/Other health care facility). Phase: Therapeutic confirmatory (Phase III). Countries: France (authorised, recruitment pending).
Therapeutic area(s): Diseases [C] - Nervous System Diseases [C10]
Gender: Female, Male. Age: 18-64 years, 65+ years. Enrolment: 486.
Status: Authorised, recruitment pending. Decision date: 2026-03-12. Results received: No. Last updated: 2026-07-21.

Condition(s): Adult patients with a LVOS with large core within 9 hours of symptoms onset or last seen well, or with a diffusion weighted imaging (DWI)-fluid attenuated inversion recovery (FLAIR) mismatch in case of unknown onset.
Product: Metalyse 5 000 units (25 mg) powder for solution for injection

Primary endpoint: The primary outcome is the rate of good functional outcome (independent ambulation) at 3 months defined as a modified Rankin scale (mRS) score of 0-3. mRS scores will be determined by certified raters unaware of the treatment arm or baseline characteristics of the individual patient by in person interview or, if not possible, by telephone.
Endpoint(s): Clinical outcomes - early neurological improvement, defined as a ≥ 8-points decrease of the NIHSS score or a NIHSS score ≤ 1 at day 1 - 3-month functional independence (mRS score ≤ 2) - distribution of 3-month mRS scores - one-year independent ambulation (mRS score ≤ 3) - one-year functional independence (mRS score ≤ 2), Radiological outcomes - successful, excellent and complete recanalisation rates defined as an extended Treatment In Cerebral Ischemia (eTICI) scores of 2b50/2b67/2c/3, 2c/3 and 3 respectively on the first angiographic run, after the first pass and at the end of the procedure - mean change in infarct volume from baseline at day 1, defined as: (day 1 volume) – (baseline volume, Safety outcomes - early neurological worsening defined as a ≥ 4-point increase on the NIHSS score within 24 hours due to the stroke itself - intracranial hemorrhage (ICH) according to the Heidelberg Bleeding Classification - symptomatic ICH, scored according to the Heidelberg Bleeding Classification - 3-month and 1-year mortality - adverse events - serious adverse events, Incremental cost-utility ratio

Source: https://euclinicaltrials.eu/ctis-public/view/2024-520414-21-00